EU clinical trial 2024-517765-16-00: A RANDOMIZED, PLACEBO-CONTROLLED, DOUBLE-BLIND, FIRST-IN-HUMAN, PHASE 1B/2A STUDY TO EVALUATE SAFETY AND EFFICACY OF SINGLE-DOSE TRI-001 IN PATIENTS WITH CHRONIC LIMB THREATENING ISCHEMIA (CLTI) DUE TO PERIPHERAL ARTERIAL DISEASE (PAD)
Protocol code: TRI-001-01
Sponsor: Ferring Ventures GmbH (Pharmaceutical company). Phase: Phase I and Phase II (Integrated)- First administration to humans. Countries: Germany (ongoing, recruiting).
Therapeutic area(s): Diseases [C] - Cardiovascular Diseases [C14]
Gender: Female, Male. Age: 18-64 years, 65+ years. Enrolment: 52.
Status: Ongoing, recruiting. Start date (EU): 2025-11-01. Decision date: 2025-04-11. Results received: No. Last updated: 2026-04-30.

Condition(s): Patients with Chronic Limb Threatening Ischemia (CLTI) due to Peripheral Arterial Disease (PAD)
Product: Placebo comparator, intramuscular injection, TRI-001

Primary endpoint: • The safety profile by assessing the occurrence of Adverse Events (AEs) and clinically significant changes in safety assessments (including vital signs, 12-lead electrocardiogram [ECG], safety laboratory testing [biochemistry, haematology, urinalysis], and other disease related safety measures) • Percentage change from baseline of the target wound size at Month 12
Endpoint(s): Key Secondary Endpoints: • Time to complete wound healing of the target wound* on the index leg • Change in rest pain score (Numeric Pain Rating Scale [NPRS], score 0-10) at Month 12 • Change in Vascular Quality of Life (VascuQoL)-6 score at Month 12 • Amputation Free Survival (AFS) of the index leg • Occurrence of Major Adverse Limb Event (MALE) of a vascular cause of the index leg • Occurrence of Major Adverse Cardiac Event (MACE), Important Secondary Endpoints: • Change in number of eligible wounds* present on the index leg at Month 12 • Change in haemodynamic and metabolic measurements of the index leg at Month 12 whenever it’s applicable: o Toe Brachial Index (TBI) o Ankle Brachial Index (ABI) o Transcutaneous oxygen pressure (TcPO2) • All-cause mortality, Other Secondary Endpoints: • Occurrence of minor amputations of the index leg

Source: https://euclinicaltrials.eu/ctis-public/view/2024-517765-16-00